EU clinical trial 2026-525766-21-01: USEFULNESS OF HIGH-FLOW OXYGEN THERAPY TO IMPROVE THE SAFETY OF PATIENTS AT HIGH RISK OF HYPOXEMIA UNDERGOING DIGESTIVE ENDOSCOPY UNDER DEEP SEDATION: A RANDOMIZED MULTICENTER COMPARATIVE STUDY. THE ENDOALF-TRIAL.
Protocol code: ICSCYL-2025-097-OXY
Sponsor: Hospital Universitario Rio Hortega (Hospital/Clinic/Other health care facility). Phase: Therapeutic use (Phase IV). Countries: Spain (authorised, recruitment pending).
Therapeutic area(s): Diseases [C] - Respiratory Tract Diseases [C08]
Gender: Female, Male. Age: 18-64 years, 65+ years. Enrolment: 326.
Status: Authorised, recruitment pending. Decision date: 2026-06-23. Results received: No. Last updated: 2026-08-06.

Condition(s): Hypoxemic episodes in patients undergoing gastroscopy, colonoscopy, or oral endoscopic ultrasound under deep sedation with oxygen therapy administration.
Product: Oxígeno Medicinal Líquido Air Liquide 99,5% v/v, gas criogénico medicinal en recipientes fijos.

Primary endpoint: Occurrence of hypoxemia, capnography waveform abnormalities, bradycardia, hypotension, arrhythmias, pulmonary aspiration, and cardiorespiratory arrest.

Source: https://euclinicaltrials.eu/ctis-public/view/2026-525766-21-01